EU clinical trial 2024-513030-38-00: A Phase III, adjudicator-blinded, randomised study to evaluate the efficacy and safety of treatment with olorofim versus treatment with AmBisome® followed by standard of care (SOC) in patients with invasive fungal disease (IFD) caused by Aspergillus species
Protocol code: F901318/0041
Sponsor: F2G Limited (Pharmaceutical company). Phase: Therapeutic confirmatory (Phase III). Countries: Italy (ended), Germany (ended), Spain (ended), Netherlands (ended), Belgium (ended), France (ended).
Therapeutic area(s): Diseases [C] - Bacterial Infections and Mycoses [C01]
Gender: Female, Male. Age: 18-64 years, 65+ years. Enrolment: 64.
Status: Ended. Start date (EU): 2022-02-15. End date (EU): 2026-01-29. End date: 2026-02-26. Decision date: 2024-06-28. Results received: No. Last updated: 2025-11-26.
Decision dates by country: ES: 2024-06-28, BE: 2024-07-01, NL: 2024-07-01, IT: 2024-07-03, FR: 2024-07-01, DE: 2024-07-03

Condition(s): Invasive fungal infections due to Aspergillus spp.
Product: AmBisome Liposomal Amphotericin B 50mg Powder for Concentrate for Dispersion for Infusion, Olorofim

Primary endpoint: The primary efficacy endpoint is the ACM rate at Day 42 in the ITT population.
Endpoint(s): Investigator-assessed overall response (integrating clinical, radiological, and mycological response) at Day 14, Day 28, Day 42, Day 84, EOT, and FU., Data Review Committee-adjudicated assessment of overall response at Day 42, Day 84, and EOT., Serum GM at Day 14, Day 28, Day 42, Day 84, EOT, and FU., All cause mortality rate at Day 84., Survival time., Data Review Committee attribution of mortality to IA at Day 42 and Day 84, Diagnosis of a secondary fungal infection at any time through EOT., Quality of life as measured by the EQ-5D-5L at baseline, Day 14, and EOT.

Source: https://euclinicaltrials.eu/ctis-public/view/2024-513030-38-00